EU clinical trial 2024-511067-29-00: A multi-center, randomized, double-blind, placebo-controlled, parallel group, phase III study to evaluate the efficacy and safety of LNP023 in primary IgA nephropathy patients
Protocol code: CLNP023A2301
Sponsor: Novartis Pharma AG (Pharmaceutical company). Phase: Therapeutic confirmatory (Phase III). Countries: Italy (ended), Netherlands (ended), Belgium (ended), Hungary (ended), Slovenia (ended), Spain (ended), Denmark (ended), France (ended), Czechia (ended), Sweden (ended), Slovakia (ended), Germany (ended).
Therapeutic area(s): Diseases [C] - Immune System Diseases [C20]
Gender: Female, Male. Age: 18-64 years, 65+ years. Enrolment: 102.
Status: Ended. Start date (EU): 2021-01-25. End date (EU): 2025-09-15. End date: 2025-09-19. Decision date: 2024-07-23. Results received: No. Last updated: 2025-05-06.
Decision dates by country: SK: 2024-07-26, IT: 2024-08-12, CZ: 2024-07-26, SE: 2024-07-23, FR: 2024-08-19, HU: 2024-07-23, ES: 2024-07-23, DE: 2024-07-24, SI: 2024-08-01, BE: 2024-07-26, NL: 2024-07-23, DK: 2024-07-25

Condition(s): IgA Nephropathy
Product: Placebo 0 mg hard gelatin capsule size 0, (placebo to LNP023 200 mg), IPTACOPAN

Primary endpoint: Primary Endpoint for Interim Analysis: •Log-transformed ratio to baseline in UPCR (sampled from 24h urine collection) at 9 months., Primary Endpoint for Final Analysis: •Annualized total eGFR slope estimated over 24 months.
Endpoint(s): Secondary Endpoint for Interim Analysis: •Change from baseline in eGFR at 9 months., Secondary Endpoint for Interim Analysis: •Proportion of participants reaching UPCR (sampled from 24h urine collection) <1g/g at 9 months, without receiving CS/IS or other newly approved drugs or initiating new background therapy for treatment of IgAN or initiating Kidney Replacement Therapy (KRT)., Secondary Endpoint for Interim Analysis: •Annualized total eGFR slope estimated over 12 months., Secondary Endpoint for Interim Analysis: •Change from baseline to 9 months in the fatigue scale measured by the FACIT-Fatigue questionnaire., Secondary Endpoint for Interim Analysis: •Safety endpoints (including adverse events/serious adverse events, safety laboratory parameters, vital signs) collected from baseline to 9 months., Secondary Endpoints for Final Analysis: •Time from randomization to first occurrence of composite kidney failure event, defined as reaching either: - sustained ≥30% decline in eGFR relative to baseline, or - sustained eGFR <15 mL/min/1.73m², or - maintenance dialysis, or - receipt of kidney transplant, or - death from kidney failure., Secondary Endpoints for Final Analysis: •Log-transformed ratio to baseline in UPCR (sampled from 24h urine collection) at 9 months., Secondary Endpoints for Final Analysis: •Proportion of participants reaching UPCR (sampled from 24h urine collection) <1g/g at 9 months without receiving CS/IS, or other newly approved drugs or initiating new background therapy for treatment of IgAN or initiating KRT., Secondary Endpoints for Final Analysis: •Change from baseline to 9 months in the fatigue scale measured by the FACIT-Fatigue questionnaire., Secondary Endpoints for Final Analysis: •Safety endpoints (including adverse events/serious adverse events, safety laboratory parameters, vital signs) collected from baseline to the End of Study (EOS).

Source: https://euclinicaltrials.eu/ctis-public/view/2024-511067-29-00